EU clinical trial 2023-506731-15-00: A Phase 2 clinical study to assess efficacy of induction carboplatin/paclitaxel + pembrolizumab for locoregionally advanced penile cancer: PRIAM
Protocol code: N22APC
Sponsor: Het Nederlands Kanker Instituut-Antoni van Leeuwenhoek Ziekenhuis Stichting (Hospital/Clinic/Other health care facility). Phase: Therapeutic exploratory (Phase II). Countries: Netherlands (ongoing, recruiting), Belgium (authorised, recruitment pending).
Therapeutic area(s): Diseases [C] - Male Urogenital Diseases [C12]; Diseases [C] - Skin and Connective Tissue Diseases [C17]
Gender: Male. Age: 18-64 years, 65+ years. Enrolment: 32.
Start date (EU): 2024-08-13. Decision date: 2024-05-21. Results received: No. Last updated: 2025-11-14.
Decision dates by country: NL: 2024-05-21, BE: 2025-04-30

Condition(s): locoregionally advanced penile cancer
Product: Paclitaxel Fresenius Kabi 6 mg/ml concentraat voor oplossing voor infusie, Carboplatine Fresenius Kabi 10 mg/ml concentraat voor oplossing voor infusie , KEYTRUDA 25 mg/mL concentrate for solution for infusion

Primary endpoint: Efficacy, defined as pathological complete response (pCR) in all patients who are evaluable for response
Endpoint(s): All-grade toxicity and treatment-related grade 3/4 toxicity by NCI-CTC-V5 will be reported in all patients who received at least one cycle of treatment, Progression-free survival, measured from day 1 of study therapy in all patients who were registered for the study and started treatment. • Overall survival, measured from day 1 of study therapy, in all patients who were registered for the study and started treatment., Overall survival, measured from day 1 of study therapy, in all patients who were registered for the study and started treatment., PFS and OS will be assessed at the primary analysis and at any later time point. Survival data will be reported as Kaplan-Meier curves. Additionally, median PFS or OS and PFS or OS at fixed time points (eg 1,2 or 3 years) may be reported.

Source: https://euclinicaltrials.eu/ctis-public/view/2023-506731-15-00